EU clinical trial 2023-503591-25-00: A Phase 3 Study of Pembrolizumab (MK-3475) in Combination with Concurrent Chemoradiation Therapy Followed by Pembrolizumab with or without Olaparib vs Concurrent Chemoradiation Therapy Followed by Durvalumab in Participants with Unresectable, Locally Advanced, Stage III Non-Small Cell Lung Cancer (NSCLC)
Protocol code: MK-7339-012
Sponsor: Merck Sharp & Dohme LLC (Pharmaceutical company). Phase: Therapeutic confirmatory (Phase III). Countries: Spain (ongoing, recruitment ended), France (ongoing, recruitment ended), Czechia (ongoing, recruitment ended), Germany (ongoing, recruitment ended), Estonia (ongoing, recruitment ended), Latvia (ongoing, recruitment ended), Italy (ongoing, recruitment ended), Hungary (ongoing, recruitment ended), Norway (ongoing, recruitment ended), Romania (ongoing, recruitment ended), Lithuania (ended), Poland (ongoing, recruitment ended).
Therapeutic area(s): Diseases [C] - Neoplasms [C04]
Gender: Female, Male. Age: 18-64 years, 65+ years. Enrolment: 295.
Start date (EU): 2020-06-09. Decision date: 2023-11-15. Results received: No. Last updated: 2026-06-03.
Decision dates by country: LT: 2023-12-13, PL: 2023-12-18, EE: 2023-11-17, IT: 2023-11-21, NO: 2023-11-16, HU: 2023-11-16, ES: 2023-11-16, RO: 2023-11-23, CZ: 2023-11-16, DE: 2023-11-17, LV: 2023-11-16, FR: 2023-11-15

Condition(s): Non-small cell lung cancer
Product: CISPLATIN, MK-7339, Olaparib Placebo, IMFINZI 50 mg/mL concentrate for solution for infusion., DURVALUMAB, PEMETREXED, ETOPOSIDE, Olaparib, CARBOPLATIN, KEYTRUDA 25 mg/mL concentrate for solution for infusion, Olaparib, PACLITAXEL

Primary endpoint: Progression-Free Survival (PFS) According to Response Evaluation Criteria in Solid Tumors Version 1.1 (RECIST 1.1) as Assessed by Blinded Independent Central Review (BICR), Overall Survival (OS)
Endpoint(s): Incidence of Adverse Events (AE), Discontinuation Rate of Study Intervention Due to an AE, Objective Response Rate (ORR) Per RECIST 1.1 as assessed by BICR, Duration of Response (DOR) Per RECIST 1.1 as assessed by BICR, Change from Baseline in European Organization for Research and Treatment of Cancer (EORTC) Quality of Life Questionnaire-Core 30 (QLQ-C30) Global Health Status/Quality of Life (Items 29 and 30) Scale Score, Change From Baseline in Cough Using the EORTC Quality of Life Questionnaire Lung Cancer Module 13 (QLQ-LC13) Item 1 Score, Change From Baseline in Chest Pain Using the EORTC QLQ-LC13 Item 10 Score, Change From Baseline in Dyspnea Using the EORTC QLQ-C30 Item 8 Score, Change From Baseline in Physical Functioning Using the EORTC QLQ-C30 Items 1- 5 Score, Change From Baseline in Role Functioning Using the EORTC QLQ-C30 Items 6-7 Score, Time to Deterioration (TTD) in health-related quality of life (HRQoL) Using the EORTC QLQ-C30 Items 29 and 30 Score, TTD in Cough Using the EORTC QLQ-LC13 Item 1 Score, TTD in Chest Pain Using the EORTC QLQ-LC13 Item 10 Score, TTD in Dyspnea Using the EORTC QLQ-C30 Item 8 Score, TTD in Physical Functioning Using the EORTC QLQ-C30 Items 1- 5 Score, TTD in Role Functioning Using the EORTC QLQ-C30 Items 6-7 Score

Source: https://euclinicaltrials.eu/ctis-public/view/2023-503591-25-00